EU clinical trial 2024-515365-34-00: The DENOCHARCOT trial. Efficacy of treatment with DENOsumab of an acute CHARCOT foot in patients with diabetes. A multicenter, double-blind, randomized, placebo-controlled trial.
Sponsor: Region Hovedstaden (Hospital/Clinic/Other health care facility). Phase: Therapeutic use (Phase IV). Countries: Denmark (ongoing, recruiting).
Therapeutic area(s): Diseases [C] - Musculoskeletal Diseases [C05]; Diseases [C] - Nutritional and Metabolic Diseases [C18]; Diseases [C] - Nervous System Diseases [C10]
Gender: Female, Male. Age: 18-64 years, 65+ years. Enrolment: 114.
Status: Ongoing, recruiting. Start date (EU): 2020-11-01. Decision date: 2024-07-04. Results received: No. Last updated: 2026-04-22.

Condition(s): diabetic acute Charcot foot (Charcot neuroarthropathy)
Product: 1 ml saline, sodiumchloride 9 mg/ml "Fresenius Kabi" for subcutaneous injection, Prolia 60 mg solution for injection in pre-filled syringe

Primary endpoint: Time from first injection of IP until the time point where the acute Charcot foot is clinically healed/in remission, ie. the temperature difference at the site maximum temperature on the affected Charcot foot is < 2 degrees Celsius compared to the similar site on the contra-lateral foot, measured using an infrared thermometer, and edema and redness of the skin has subsided – at two subsequent visits 4 weeks apart.
Endpoint(s): Fraction of clinical healed participants at each study visit. Fraction of healing on X-rays and MRI (or PET/CT or Scintigram) at the time of clinical healing and at the End of trial. Number of relapses (defined as need for/prescription of off- loading with cast of the Charcot foot again) ...

Source: https://euclinicaltrials.eu/ctis-public/view/2024-515365-34-00